EU clinical trial 2025-520550-11-00: Swedish Cardiac And Renal Failure study-1 (SCARF-1): An open-label pilot trial to evaluate the feasibility, safety and efficacy of eplerenone in patients with heart failure with reduced ejection fraction and severe chronic kidney disease.
Protocol code: SCARF-1
Sponsor: Karolinska Institutet (Educational Institution). Phase: Therapeutic exploratory (Phase II). Countries: Sweden (authorised, recruitment pending).
Therapeutic area(s): Diseases [C] - Cardiovascular Diseases [C14]
Gender: Female, Male. Age: 18-64 years, 65+ years. Enrolment: 40.
Status: Authorised, recruitment pending. Decision date: 2025-08-12. Results received: No. Last updated: 2026-01-26.

Condition(s): Heart failure with reduced ejection fraction in combination with severe chronic kidney disease
Product: EPLERENONE

Primary endpoint: The primary endpoint is the proportion of subjects who complete the entire treatment period with and without the need to use a potassium binder.
Endpoint(s): Change in Kansas City Cardiomyopathy Questionnaire (KCCQ) total symptom score, Change in six-minute walk distance (6MWD), Change in N-terminal pro b-type natriuretic peptide (NTpro-BNP), Change in eGFR and urine-albumin-creatinine-ratio (UACR), Safety endpoint: The occurrence of plasma potassium (P-K) ≥ 5.5 and ≥ 6.0, Safety endpoint: Hospitalization for hyperkalemia, Safety endpoint: The occurrence of P-K < 3.0, Safety endpoint: Hospitalization for hypokalemia, Safety endpoint: Decrease in eGFR of ≥ 30% and ≥ 50%, Safety endpoint: Hospitalization for renal failure, Safety endpoint: Initiation of dialysis, Safety endpoint: Subject-reported syncope, Safety endpoint: Subject-reported lightheadedness due to orthostatic hypotension as judged by the investigator, Safety endpoint: Any subject-reported side effect, Safety endpoint: Hospitalization for HF, Safety endpoint: All cause hospitalization, Safety endpoint: Cardiovascular (CV) death, Safety endpoint: All cause death

Source: https://euclinicaltrials.eu/ctis-public/view/2025-520550-11-00